EU clinical trial 2023-503571-19-00: A Phase III, Multicentre, Randomized, Double-blind, Chronic-dosing, Parallel-group, Placebo-controlled Study to Evaluate the Efficacy and Safety of Two Dose Regimens of Tozorakimab in Participants with Symptomatic Chronic Obstructive Pulmonary Disease (COPD) with a History of COPD Exacerbations (Oberon)
Protocol code: D9180C00003
Sponsor: AstraZeneca AB (Pharmaceutical company). Phase: Therapeutic confirmatory (Phase III). Countries: Czechia (ended), Denmark (ended), Bulgaria (ended), Netherlands (ended), Belgium (ended), Finland (ended), Hungary (ended), Portugal (ended), Sweden (ended), Spain (ended), Norway (ended).
Therapeutic area(s): Diseases [C] - Respiratory Tract Diseases [C08]
Gender: Female, Male. Age: 18-64 years, 65+ years. Enrolment: 479.
Status: Ended. Start date (EU): 2022-01-20. End date (EU): 2026-03-11. End date: 2026-03-12. Decision date: 2024-02-28. Results received: No. Last updated: 2026-04-01.
Decision dates by country: BG: 2024-02-28, HU: 2024-05-02, FI: 2024-02-28, DK: 2024-02-28, CZ: 2024-03-01, BE: 2024-03-11, NL: 2024-02-28, NO: 2024-02-29, ES: 2024-04-26, PT: 2024-05-02, SE: 2024-02-29

Condition(s): Chronic Obstructive Pulmonary Disease (COPD)
Product: Tozorakimab-placebo, Tozorakimab, SALBUTAMOL

Primary endpoint: Annualized rate of moderate to severe COPD exacerbations in participants who are former smokers.

Source: https://euclinicaltrials.eu/ctis-public/view/2023-503571-19-00